EU clinical trial 2023-507206-13-00: J2A-MC-GZGV: A Phase 3, Randomized, Open-Label Study to Investigate the Efficacy and Safety of Once Daily Oral Orforglipron Compared with Dapagliflozin in Adult Participants with Type 2 Diabetes and Inadequate Glycemic Control with Metformin (ACHIEVE-2)
Protocol code: J2A-MC-GZGV
Sponsor: Eli Lilly & Co. (Pharmaceutical company). Phase: Therapeutic confirmatory (Phase III). Countries: Poland (ended), Germany (ended).
Therapeutic area(s): Diseases [C] - Nutritional and Metabolic Diseases [C18]
Gender: Female, Male. Age: 18-64 years, 65+ years. Enrolment: 266.
Status: Ended. Start date (EU): 2024-03-14. End date (EU): 2025-09-26. End date: 2025-09-27. Decision date: 2024-02-14. Results received: No. Last updated: 2026-06-15.
Decision dates by country: PL: 2024-04-29, DE: 2024-04-29

Condition(s): Type 2 Diabetes
Product: DAPAGLIFLOZIN, ORFORGLIPRON, Orforglipron, ORFORGLIPRON, ORFORGLIPRON, ORFORGLIPRON, ORFORGLIPRON, METFORMIN

Primary endpoint: Change from Baseline in Hemoglobin A1c (HbA1c)

Source: https://euclinicaltrials.eu/ctis-public/view/2023-507206-13-00